EU clinical trial 2023-504954-37-00: A clinical study of MK-6552 in healthy adults (MK-6552-002)
Protocol code: MK-6552-002
Sponsor: Merck Sharp & Dohme LLC (Pharmaceutical company). Phase: Human Pharmacology (Phase I)- Other. Countries: Belgium (ended).
Therapeutic area(s): Diseases [C] - Nervous System Diseases [C10]
Gender: Female, Male. Age: 18-64 years. Enrolment: 64.
Status: Ended. Start date (EU): 2023-07-07. End date (EU): 2024-08-29. End date: 2024-08-30. Decision date: 2023-07-03. Results received: No. Last updated: 2024-05-15.

Condition(s): Narcolepsy

Source: https://euclinicaltrials.eu/ctis-public/view/2023-504954-37-00